EU clinical trial 2024-517104-11-00: A Phase IIa, Randomized, Double-Masked, Placebo-Controlled, Parallel-Group, Multicenter Study Assessing the Efficacy and Safety of STN1010904 Ophthalmic Suspension 0.03% and 0.1% Compared with Vehicle in Subjects with Fuchs Endothelial Corneal Dystrophy (FECD) - PHANTOM Study
Protocol code: 101090401IN
Sponsor: Santen Inc. (Pharmaceutical company). Phase: Therapeutic exploratory (Phase II). Countries: France (ended).
Therapeutic area(s): Phenomena and Processes [G] - Ocular Physiological Phenomena [G14]
Gender: Female, Male. Age: 18-64 years, 65+ years. Enrolment: 15.
Status: Ended. Start date (EU): 2023-06-08. End date (EU): 2025-05-26. Decision date: 2024-10-04. Results received: Yes. Last updated: 2025-04-01.

Condition(s): Fuchs Endothelial Corneal Dystrophy (FECD)
Product: STN1010904, Placebo (vehicle), STN1010904

Primary endpoint: Primary Efficacy Endpoints: - Change from baseline in best corrected visual acuity (BCVA) with contrast level of 100% at Month 18 - Change from baseline in BCVA with contrast level of 10% at Month 18 - Change from baseline in contrast sensitivity with glare light at Month 18, Safety Endpoint: - Safety of DE-109D will be assessed by adverse events (AEs), slit-lamp biomicroscopy, indirect ophthalmoscopy, intraocular pressure (IOP), and laboratory tests (serum chemistry, hematology, and urinalysis).
Endpoint(s): Secondary Efficacy Endpoints: - Best corrected visual acuity (BCVA) with contrast level of 100% at all postbaseline visits - BCVA with contrast level of 10% at all post-baseline visits - Contrast sensitivity with glare light at all post-baseline visits - Contrast sensitivity without glare light at all post-baseline visits., - Change and percent change from baseline in BCVA with contrast level of 100% at all post-baseline visits - Change and percent change from baseline in BCVA with contrast level of 10% at all post-baseline visits - Change and percent change from baseline in contrast sensitivity with glare light at all post-baseline visits, - Change and percent change from baseline in contrast sensitivity without glare light at all post-baseline visits - Change and percent change from baseline in central corneal thickness at all post-baseline visits. - Change and percent change from baseline in endothelial cell density at all post-baseline visits., - Change and percent change in Guttae formation (Modified Krachmer scale) at all post-baseline visits

Source: https://euclinicaltrials.eu/ctis-public/view/2024-517104-11-00